EU clinical trial 2023-508861-34-00: CASPONEB - Phase II safety lead-in randomized blind placebo controlled clinical trial : efficacy and safety of caspofungin aerosols for the curative treatment of Pneumocystis pneumonia in adjunction of conventional systemic antifungal therapy
Protocol code: DR220214
Sponsor: Centre Hospitalier Regional Universitaire De Tours (Hospital/Clinic/Other health care facility). Phase: Phase I and Phase II (Integrated)- Other. Countries: France (ongoing, recruiting).
Therapeutic area(s): Diseases [C] - Parasitic Diseases [C03]
Gender: Female, Male. Age: 18-64 years, 65+ years. Enrolment: 96.
Status: Ongoing, recruiting. Start date (EU): 2025-12-02. Decision date: 2025-02-25. Results received: No. Last updated: 2025-02-25.

Condition(s): Pneumocystis pneumonia

Source: https://euclinicaltrials.eu/ctis-public/view/2023-508861-34-00